EU clinical trial 2022-502179-48-00: A Randomized, Open-Label, Single-Dose, Parallel-Group Study to Evaluate the Relative Bioavailability of LY03010 versus Xeplion® after Intramuscular Injection in Healthy Subjects
Protocol code: LY03010/CT-EUR-101
Sponsor: Geneora Pharma (Shijiazhuang) Co. Ltd. (Pharmaceutical company). Phase: Human Pharmacology (Phase I)- Bioequivalence Study. Countries: Portugal (ended).
Therapeutic area(s): Diseases [C] - Nervous System Diseases [C10]
Gender: Female, Male. Age: 18-64 years. Enrolment: 170.
Status: Ended. Start date (EU): 2023-02-23. End date (EU): 2024-02-12. Decision date: 2023-02-20. Results received: No. Last updated: 2024-02-28.

Condition(s): Schizophrenia

Source: https://euclinicaltrials.eu/ctis-public/view/2022-502179-48-00